EU clinical trial 2023-509293-29-00: A study in healthy people to test how well different doses of BI 3000202 are tolerated and how they affect the way the body handles midazolam
Protocol code: 1509-0002
Sponsor: Boehringer Ingelheim International GmbH (Pharmaceutical company). Phase: Human Pharmacology (Phase I)- Other. Countries: Belgium (ended).
Therapeutic area(s): Not possible to specify
Gender: Female, Male. Age: 18-64 years. Enrolment: 60.
Status: Ended. Start date (EU): 2024-03-28. End date (EU): 2024-09-27. Decision date: 2024-03-18. Results received: No. Last updated: 2024-09-20.

Condition(s): Healthy volunteer trial

Source: https://euclinicaltrials.eu/ctis-public/view/2023-509293-29-00